EU clinical trial 2023-510519-20-00: SYNERGY OSA - EFFICACY, SAFETY and TOLERABILITY OF COMBINED THERAPY WITH A SOMNOMED ORAL APPLIANCE AND THE CARBONIC ANHYDRASE INHIBITOR SULTHIAME IN PATIENTS WITH OBSTRUCTIVE SLEEP APNEA. A Randomized, Double-Blind, Placebo Controlled, Proof-of-Concept Trial
Sponsor: Vaestra Goetalandsregionen (Hospital/Clinic/Other health care facility). Phase: Therapeutic exploratory (Phase II). Countries: Denmark (ongoing, recruitment ended), Sweden (ongoing, recruitment ended).
Therapeutic area(s): Diseases [C] - Nervous System Diseases [C10]
Gender: Female, Male. Age: 18-64 years, 65+ years. Enrolment: 50.
Status: Ongoing, recruitment ended. Start date (EU): 2024-12-12. Decision date: 2024-09-23. Results received: No. Last updated: 2024-09-24.
Decision dates by country: DK: 2024-09-23, SE: 2024-09-24

Condition(s): Obstructive sleep apnea with an incomplete clinical response to oral appliance therapy.
Product: Placebo - same composition as IMP except for the active substance, Ospolot 50 mg, Filmtabletten

Primary endpoint: Reduction of the apnea/hypopnea index (AHI3a), in patients with an insufficient (AHI3a ≥15) therapeutic effect of an OAT, after STM 200 mg vs. placebo in a 2 week cross-over protocol
Endpoint(s): Change in other OSA-related variables (AHI4), mean overnight SpO2, minimum SpO2, oxygen desaturation index 4% and hypoxic burden) as well as objective measures of sleep (sleep stages, total sleep time, arousal index, sleep efficacy) assessed by polysomnography (PSG) in patients with an insufficient therapeutic effect of an OAT after adding STM vs. placebo for 2 weeks in a cross-over protocol., Exploratory endpoints including change from baseline and cross-over comparison. Effect of STM relative to placebo with respect to:, • Questionnaires on daytime functioning (ESS, FOSQ, CGI-S, CGI-I, PGI-S, SF-36, PGI-I, and C-SSRS) such as sleepiness, wellbeing, mood, and measures of quality of life under the dosing circumstances outlined above., • Other PSG variables (NREM AHI, REM AHI, supine AHI, RERA, EEG), • Effect on potential biomarkers of OSA including change in whole blood carbonic anhydrase (CA) activity, venous blood gases, concentration of carbonic anhydrase isoenzyme IX (CA-IX), circulating markers of hypoxemia including HIF-1a or phenotypic characteristics of upper airway function and stability during sleep under the dosing circumstances., • Influence of conventional comorbidities in OSA, such as BMI., • Change in vital signs and biochemical markers including blood pressure, glycemic control and lipids.

Source: https://euclinicaltrials.eu/ctis-public/view/2023-510519-20-00